EU clinical trial 2024-518486-10-00: A phase II prospective, open-label, multi-centre, single arm study of sasanlimab plus sacituzumab govitecan in BCG (Bacillus Calmette-Guérin)- unresponsive non-muscle invasive bladder cancer (NMIBC) patients.
Protocol code: APRO07-2022
Sponsor: Associacio Per A La Recerca Oncologica (Laboratory/Research/Testing facility). Phase: Therapeutic exploratory (Phase II). Countries: Spain (ongoing, recruitment ended).
Therapeutic area(s): Diseases [C] - Neoplasms [C04]
Gender: Female, Male. Age: 18-64 years, 65+ years. Enrolment: 42.
Status: Ongoing, recruitment ended. Start date (EU): 2023-02-23. Decision date: 2024-10-25. Results received: No. Last updated: 2026-07-25.

Condition(s): Non-Muscle Invasive Bladder Cancer
Product: PF-06801591, Trodelvy 200 mg powder for concentrate for solution for infusion

Primary endpoint: Complete Response (CR) Rate of high-grade disease at 3 months (defined as the absence of high-risk disease or progressive disease, assessed by cystoscopy and urine cytology, and biopsy (when applicable)
Endpoint(s): Adverse events (AEs)., CR rate of high-risk disease at 6, 12, 18 and 24 months., Median duration of complete response (DOR) in patients with a Complete response (CR)., Progression-free survival (PFS) to worsening of grade, stage (muscle invasive or metastatic disease) or death., Overall Survival (OS)., 6-month, 12-month, 18-month and 24-month OS and PFS to worsening of grade, stage (muscle-invasive or metastatic disease) or death.

Source: https://euclinicaltrials.eu/ctis-public/view/2024-518486-10-00